EU clinical trial 2022-502825-17-00: A Phase 2 Peri-operative Trial of Fianlimab and Cemiplimab Compared with Anti-PD1 Alone in Patients with Resectable Stage III and IV Melanoma
Protocol code: R3767-ONC-2208
Sponsor: Regeneron Pharmaceuticals Inc. (Pharmaceutical company). Phase: Therapeutic exploratory (Phase II). Countries: Italy (ongoing, recruitment ended), Greece (ended), Spain (ongoing, recruitment ended), France (ongoing, recruitment ended), Germany (ongoing, recruitment ended), Austria (ongoing, recruitment ended), Ireland (ended), Poland (ended).
Therapeutic area(s): Diseases [C] - Neoplasms [C04]
Gender: Female, Male. Age: 18-64 years, 65+ years. Enrolment: 254.
Start date (EU): 2024-10-07. Decision date: 2024-09-30. Results received: No. Last updated: 2026-08-03.
Decision dates by country: IE: 2024-10-04, GR: 2024-10-01, PL: 2025-01-10, IT: 2024-10-01, DE: 2024-10-04, ES: 2024-09-30, AT: 2024-10-07, FR: 2024-10-04

Condition(s): Melanoma
Product: Cemiplimab and Fianlimab - 1, Cemiplimab & Fianlimab - 2, Placebo for Fianlimab, LIBTAYO 350 mg concentrate for solution for infusion., Fianlimab

Primary endpoint: Pathological complete response (pCR) rate as assessed by Blinded Independent Pathological Review (BIPR)
Endpoint(s): pCR rate as assessed by local pathologic review, Event-Free Survival (EFS), Distant metastasis-free survival (DMFS), Overall survival (OS), Major pathological response (MPR) as assessed by BIPR, MPR rate as assessed by local pathologic review, Objective Response Rate (ORR) assessed by investigator per RECIST 1.1 criteria, ORR assessed by Blinded Independent Central Review (BICR) per RECIST 1.1 criteria, Relapse-free survival (RFS), Occurrence of treatment-emergent adverse events (TEAEs), Occurrence of immune-mediated adverse events (imAEs), Occurrence of serious adverse events (SAEs), Occurrence of adverse events of special interest (AESIs), Occurrence of TEAEs resulting in death, Occurrence of interruption or discontinuation of study drug(s) due to TEAE., Occurrence of cancellation of surgery due to TEAE or delay to surgery, Occurrence of laboratory abnormalities, Concentrations of fianlimab in serum, Concentrations of cemiplimab in serum, Anti-drug antibodies (ADA) in serum to fianlimab, ADA in serum to cemiplimab, Change from baseline in disease-related symptoms per Functional Assessment of Cancer Therapy-Melanoma (FACT-M) subscale, Change from baseline in functioning per European Organization for Research and Treatment of Cancer Quality of Life Questionnaire (QoL) C30 (EORTC QLQ-C30), Change from baseline in global health status/QoL per EORTC QLQ-C30, Change from baseline in overall health state per European Quality of Life Dimension 5 (EQ-5D-5L)

Source: https://euclinicaltrials.eu/ctis-public/view/2022-502825-17-00